EU clinical trial 2023-510030-83-00: A Randomized, Double-Blind, Placebo-Controlled Study to Assess the Efficacy and Safety of Two Dose Regimens (60 mg/kg and 120 mg/kg) of Weekly Intravenous Alpha1-Proteinase Inhibitor (Human) in Subjects with Pulmonary Emphysema due to Alpha1-Antitrypsin Deficiency
Protocol code: GTi1201
Sponsor: Grifols Therapeutics LLC (Pharmaceutical company). Phase: Therapeutic confirmatory (Phase III). Countries: Finland (ongoing, recruitment ended), Sweden (ended), Poland (ongoing, recruitment ended), France (ended), Denmark (ended).
Therapeutic area(s): Diseases [C] - Respiratory Tract Diseases [C08]
Gender: Female, Male. Age: 18-64 years, 65+ years. Enrolment: 170.
Start date (EU): 2014-01-29. Decision date: 2024-08-21. Results received: No. Last updated: 2026-07-22.
Decision dates by country: DK: 2024-08-22, FR: 2024-08-23, PL: 2024-10-01, SE: 2024-08-21, FI: 2024-08-21

Condition(s): Pulmonary Emphysema due to Alpha-1-Antitrypsin Deficiency
Product: ALPHA-1-PROTEINASE INHIBITOR (HUMAN), Placebo to be used in this clinical trial is 0.9% sodium chloride injection, united states pharmacopeia (0.9% nacl, usp) (please refer to section 1.6.3 placebo rationale and 3.3 treatments – 3.3.1.2 placebo in the protocol for a more detailed description).

Primary endpoint: The primary variable to assess efficacy in this study is whole lung PD15 using CT densitometry.
Endpoint(s): Severe COPD exacerbations as defined by ATS/ERS criteria (i.e., COPD exacerbations that require hospitalization), PD15 of the basal lung region using CT densitometry.

Source: https://euclinicaltrials.eu/ctis-public/view/2023-510030-83-00